EU clinical trial 2023-509221-47-00: A Multicenter, Randomized, Double-Blind, Placebo-Controlled, Phase III Study of ARN-509 in Men with Non-Metastatic (M0) Castration-Resistant Prostate Cancer
Protocol code: ARN-509-003
Sponsor: Aragon Pharmaceuticals Inc. (Pharmaceutical company). Phase: Therapeutic confirmatory (Phase III). Countries: Austria (ended), Romania (ended), Netherlands (ongoing, recruitment ended), Poland (ended), Germany (ended), Spain (ongoing, recruitment ended), Czechia (ongoing, recruitment ended), France (ended), Denmark (ended), Belgium (ended), Slovakia (ongoing, recruitment ended), Italy (ended).
Therapeutic area(s): Diseases [C] - Neoplasms [C04]
Gender: Male. Age: 18-64 years, 65+ years. Enrolment: 30.
Start date (EU): 2014-02-12. Decision date: 2024-03-01. Results received: No. Last updated: 2026-07-29.
Decision dates by country: AT: 2024-04-17, BE: 2024-03-27, PL: 2024-04-10, FR: 2024-03-15, RO: 2024-03-06, SK: 2024-03-01, NL: 2024-03-01, DK: 2024-03-01, IT: 2024-04-03, DE: 2024-03-07, ES: 2024-03-05, CZ: 2024-03-04

Condition(s): Castration-Resistant Prostate Cancer
Product: ZYTIGA 250 mg tablets, PREDNISONE, Apalutamide placebo, ZYTIGA 500 mg film-coated tablets, JNJ-56021927

Primary endpoint: Metastasis-Free Survival (MFS)
Endpoint(s): For the secondary endpoints, a hierarchical testing will be performed in the following order: -Time to Metastasis (TTM) -Progression-Free Survival (PFS) -Time to symptomatic progression -Overall Survival (OS) -Time to initiation of cytotoxic chemotherapy

Source: https://euclinicaltrials.eu/ctis-public/view/2023-509221-47-00